EU clinical trial 2023-507440-36-00: Unravelling the local and systemic effects of primary surgery and perioperative use of ketorolac and pregabalin in primary breast cancer patients according to adiposity
Protocol code: IJB-KEPREST-2022
Sponsor: Institut Jules Bordet (Hospital/Clinic/Other health care facility). Phase: Therapeutic exploratory (Phase II). Countries: Belgium (ongoing, recruiting).
Therapeutic area(s): Diseases [C] - Neoplasms [C04]
Gender: Female. Age: 18-64 years, 65+ years. Enrolment: 120.
Status: Ongoing, recruiting. Start date (EU): 2025-05-12. Decision date: 2025-01-24. Results received: No. Last updated: 2025-03-24.

Condition(s): Estrogen receptor-positive early breast cancer (ER + BC).
Product: KETOROLAC, PREGABALIN

Primary endpoint: To detect a different increase in systemic inflammation using peri-operative ketorolac as assessed by Interleukin (IL) 6 in the blood in treated subjects versus observation arm using mean differences in percentage change of IL 6 between baseline and T4., To detect a different increase in systemic neurotransmitters using peri-operative pregabalin as assessed by Norepinephrine (NE) in the blood in treated subjects versus untreated observation arm using mean difference in percentage change of NE from baseline to T4.
Endpoint(s): At local level (tumour): To assess, in treated subjects versus untreated subjects, at the time of surgery (T3) compared to pre-treatment diagnosis biopsy (T0) and according to subject’s adiposity, Decrease of biomarkers of metastatic progression: Epithelial to Mesenchymal Transition (EMT) markers and pro-metastatic transcription factors, Increase in recruitment of specific immune cell subpopulations: Tumour-infiltrating leukocyte subpopulations (monocytes/macrophages, dendritic cells, NK, T and B lymphocytes), Decrease in neurogenesis: Neurotrophins: Neuronal growth factor (NGF) and Brain Derived neurotrophic factors (BDNF), Neuronal marker for neuronal plasticity: Stathmin-2 (STMN2), Decrease of neurotransmitters: Sensitive neurotransmitters: Calcitonine Gene Related Peptide (CGRP), Substance P (SP), Parasympathetic neurotransmitter: Acetylcholin (Ach), Sympathetic neurotransmitter: Norepinephrine (NE), Modification in spatial -omics: Transcriptomics, Metabolomics/ Lipidomics, Proteomics, At systemic level (blood): • To assess perioperatively (T0, T2 to T5) and according to subject’s adiposity, the variations between treated and non-treated subjects: • Increased cytotoxic immunity o IL12, IFNɣ, classical monocytes, dendritic cells and NK cells activity, Decrease of surgery-induced humoral immunity: CRP, IL10, cortisol, To assess perioperatively (T2, T3, T4, T5) and according to subject’s adiposity, variations between treated and non-treated subjects and variations between pre-(T0) and post-(T2) treatment: • Decrease of neurotransmitter levels o Neurotransmitters: CGRP, SP, E and NE o Neurotrophin: NGF, To assess at clinical level: Decrease in anxiety level (T0 vs T1), in pregabalin treated versus non pregabalin treated subjects • Generalized Anxiety Disorder - 7 (GAD-7), Decrease of perioperative pain, at time of surgery, between treated and non-treated subjects, and according to the type of treatment (T3, T4, T5) • NRS (Numeric Rating scale) • Morphine consumption, Subject’s lifestyle (to assess once before surgery, at T1) • Lifestyle questionnaire • Clinical measurement of adiposity • Evaluation of muscular strength, To detect a different increase in systemic inflammation using peri-operative ketorolac as assessed by Interleukin (IL) 6 in the blood in treated subjects versus observation arm using mean differences in percentage change of IL 6 at each timepoints, from T0 to T5., To detect a different increase in systemic neurotransmitters using peri-operative pregabalin as assessed by Norepinephrine (NE) in the blood in treated subjects versus untreated observation arm using mean difference in percentage change of NE at each timepoints, from T0 to T5., To exclude, in treated versus untreated subjects, a potential increase in harm and risk associated with the preoperative use of IMP in breast cancer surgery (T2 to 30 days after the planned surgery),, to assess: o Intensity of any Adverse Events (from T2 to 30 days after the planned surgery) ▪ NCI-CTCAE version 5.0 o Intensity of intraoperative Adverse Events (iAEs) (from T2 to T3) ▪ ClassIntra® v1.0 o Intensity of postoperative Adverse Events (poAEs) (from T2 to 30 days after the planned surgery) ▪ Clavien-Dindo classification

Source: https://euclinicaltrials.eu/ctis-public/view/2023-507440-36-00